EU clinical trial 2025-522826-11-00: Longitudinal study with positron emission tomography using [18F]PI-2620 in primary tauopathies. Proof-of-concept study
Protocol code: BIS-FPI-2025-01
Sponsor: ZRO Imaging AB (Hospital/Clinic/Other health care facility). Phase: Phase I and Phase II (Integrated)- Other. Countries: Spain (ongoing, recruiting).
Therapeutic area(s): Diseases [C] - Nervous System Diseases [C10]; Analytical, Diagnostic and Therapeutic Techniques and Equipment [E] - Diagnosis [E01]
Gender: Female, Male. Age: 18-64 years, 65+ years. Enrolment: 64.
Status: Ongoing, recruiting. Start date (EU): 2025-11-06. Decision date: 2025-11-03. Results received: No. Last updated: 2026-04-13.

Condition(s): Corticobasal syndrome (CBS), Progressive supranuclear palsy (PSP), Behavioral variant frontotemporal dementia (bvFTD).

Source: https://euclinicaltrials.eu/ctis-public/view/2025-522826-11-00